EU clinical trial 2025-524285-18-00: A Phase 2 Open-Label, Multi-Center Study of BMS-986504 as Monotherapy and in Combination with Other Agents in Participants with Advanced and/or Metastatic Solid Tumors with Homozygous MTAP Deletion
Protocol code: CA240-0005
Sponsor: Bristol-Myers Squibb Services Unlimited Company (Pharmaceutical company). Phase: Therapeutic exploratory (Phase II). Countries: Belgium (authorised, recruitment pending), Ireland (authorised, recruitment pending), Germany (authorised, recruitment pending), Norway (authorised, recruitment pending), Italy (authorised, recruitment pending), France (authorised, recruitment pending), Spain (authorised, recruitment pending).
Therapeutic area(s): Diseases [C] - Neoplasms [C04]
Gender: Female, Male. Age: 18-64 years, 65+ years. Enrolment: 123.
Status: Authorised, recruitment pending. Decision date: 2026-07-07. Results received: No. Last updated: 2026-07-14.
Decision dates by country: BE: 2026-07-08, FR: 2026-07-10, DE: 2026-07-07, IE: 2026-07-10, ES: 2026-07-13, NO: 2026-07-07, IT: 2026-07-14

Condition(s): Advanced and/or Metastatic Solid Tumors with Homozygous MTAP Deletion
Product: TEMOZOLOMIDE, TEMOZOLOMIDE, TEMOZOLOMIDE, BNT327 20 mg ml, TEMOZOLOMIDE, PACLITAXEL ALBUMIN-BOUND, TEMOZOLOMIDE, TEMOZOLOMIDE, BNT327 50 mg ml, GEMCITABINE, CISPLATIN, Navlimetostat, CARBOPLATIN, PEMETREXED, PACLITAXEL

Primary endpoint: Achievement of OR- confirmed complete response (CR) or partial response (PR), To check how safe and tolerable different dose levels of BMS‑986504 are when it is given together with other cancer treatments in participants with advanced/metastatic tumor with MTAP gene deletion or MTAP loss.
Endpoint(s): TTOR- the time from first dose to the date of the first documentation of objective tumor response (CR or PR), DOR (CR or PR)- the time between the date of the first documentation of objective tumor response and the date of disease progression or to death from any cause (whichever occurs first), Achievement of DC- best overall response (BOR) of confirmed CR, confirmed PR, or stable disease (SD), Incidence and severity of adverse events (AEs), serious adverse events (SAEs), treatment related AEs and SAEs, AEs leading to study treatment discontinuation, deaths and laboratory abnormalities, Achievement of CB- BOR of confirmed CR, confirmed PR, or SD for at least 4 months after start of treatment, OR, DC, DOR, TTOR and CBof BMS-986504 in combination with other anti-cancer treatments

Source: https://euclinicaltrials.eu/ctis-public/view/2025-524285-18-00